EU clinical trial 2024-518551-37-00: Effects of DAPAgliflozin on cardiopulmonary exercise capacity and hemodynamics in Pulmonary Arterial Hypertension: A double blind randomized trial. (DAPAH-trial)
Sponsor: Rigshospitalet (Hospital/Clinic/Other health care facility). Phase: Therapeutic exploratory (Phase II). Countries: Denmark (ended).
Therapeutic area(s): Diseases [C] - Cardiovascular Diseases [C14]
Gender: Female, Male. Age: 18-64 years, 65+ years. Enrolment: 52.
Status: Ended. Start date (EU): 2023-01-01. End date (EU): 2026-01-13. Decision date: 2024-10-23. Results received: No. Last updated: 2024-10-23.

Condition(s): Chronic thromboembolic pulmonary hypertension, Pulmonary arterial hypertension
Product: PLACEBO, Forxiga 10 mg film-coated tablets

Primary endpoint: Change in maximum oxygen consumption (VO2 max) measured by cardiopulmonary exercise testing from baseline to follow up after ninety days between dapagliflozin and placebo
Endpoint(s): Change in 6-minute walking distance (6MWD) from baseline to follow up after three months, Change in VE/VCO2 from baseline to follow up after ninety days, Change in mean pulmonary artery pressure (meanPAP) from baseline to follow up after ninety days, Change in cardiac index (CI) and pulmonary vascular resistance (PVR) from baseline to follow up after ninety days, Change in central venous pressure (CVP) from baseline to follow up after ninety days, Change in transpulmonary gradient from baseline to follow up after ninety days, Change in pulmonary arterial compliance (sysPAP/strokevolume) from baseline to follow up after ninety days, Change in right ventricular (RV) size as assessed by 3D echocardiography from baseline to follow up after ninety days, Change in right ventricular (RV) free wall strain from baseline to follow up after three months, Change in right ventricular (RV) free wall strain-work (RV-LS / meanPAP) from baseline to follow up after ninety days, Change in plasma NT-proBNP from baseline to follow up after ninety days, Change in EQ-5D-5L questionnaire from baseline to follow up after ninety days, Change in metabolomic and proteomic patterns from baseline to follow up after three months, Changes in selected biomarkers, se section on biomarkers from baseline to follow up after ninety days

Source: https://euclinicaltrials.eu/ctis-public/view/2024-518551-37-00